EU clinical trial 2023-509176-42-00: Efficacy, safety and pharmacokinetics of cagrilintide s.c. 2.4 mg as monotherapy and in combination with semaglutide s.c. 2.4 mg (CagriSema) once weekly for weight management in children and adolescents with overweight or obesity
Protocol code: NN9838-4968
Sponsor: Novo Nordisk A/S (Pharmaceutical company). Phase: Phase III and phase IV (Integrated). Countries: Slovakia (authorised, recruitment pending), Austria (authorised, recruitment pending), Spain (authorised, recruitment pending), Romania (authorised, recruitment pending), Portugal (authorised, recruitment pending), Italy (authorised, recruitment pending), Denmark (authorised, recruitment pending), Belgium (authorised, recruitment pending), Sweden (not authorised), Poland (authorised, recruitment pending), Netherlands (authorised, recruitment pending), Croatia (authorised, recruitment pending), Hungary (authorised, recruitment pending), Bulgaria (authorised, recruitment pending).
Therapeutic area(s): Diseases [C] - Nutritional and Metabolic Diseases [C18]
Gender: Female, Male. Age: 0-17 years. Enrolment: 157.
Decision date: 2026-04-28. Results received: No. Last updated: 2026-05-04.
Decision dates by country: AT: 2026-04-30, BE: 2026-04-28, BG: 2026-05-04, HR: 2026-05-04, DK: 2026-04-28, HU: 2026-05-04, IT: 2026-04-29, PT: 2026-04-30, RO: 2026-05-04, ES: 2026-05-04, SE: 2026-04-29, NL: 2026-04-29, PL: 2026-04-30, SK: 2026-04-29

Condition(s): Obesity and T2D
Product: cagrilintide, Placebo + Placebo, semaglutide, cagrilintide, cagrilintide semaglutide, semaglutide, semaglutide, semaglutide, cagrilintide semaglutide, semaglutide, cagrilintide semaglutide, cagrilintide semaglutide, cagrilintide semaglutide, cagrilintide, cagrilintide

Primary endpoint: Relative change in body mass index (BMI). Baseline (week 0) to end of treatment (week 68). Unit: %.
Endpoint(s): Relative change in body weight. Baseline (week 0) to end of treatment (week 68). Unit: %., Change in BMI Standard Deviation Score (SDS). Baseline (week 0) to end of treatment (week 68). Unit: SDS score, Relative change in BMI. Baseline (week 0) to end of treatment (week 68). Unit: %., Relative change in body weight. Baseline (week 0) to end of treatment (week 68). Unit: %., Change in BMI Standard Deviation Score (SDS). Baseline (week 0) to end of treatment (week 68). Unit: SDS score., Reduction in weight category. Baseline (week 0) to end of treatment (week 68). Unit: count of participant., Reduction in weight category. Baseline (week 0) to end of treatment (week 68). Unit: count of participant.

Source: https://euclinicaltrials.eu/ctis-public/view/2023-509176-42-00